EU clinical trial 2024-511452-40-00: GBM AGILE Global Adaptive Trial Master Protocol: An International, Seamless Phase II/III Response Adaptive Randomization Platform Trial Designed To Evaluate Multiple Regimens In Newly Diagnosed and Recurrent Glioblastoma (GBM)
Protocol code: GCAR-7213
Sponsor: Global Coalition For Adaptive Research Inc. (Pharmaceutical company). Phase: Phase II and Phase III (Integrated). Countries: Germany (ongoing, recruitment ended), France (ongoing, recruitment ended).
Therapeutic area(s): Diseases [C] - Neoplasms [C04]
Gender: Female, Male. Age: 18-64 years, 65+ years. Enrolment: 120.
Status: Ongoing, recruitment ended. Start date (EU): 2025-09-12. Decision date: 2024-07-16. Results received: No. Last updated: 2026-02-11.
Decision dates by country: FR: 2024-07-16, DE: 2024-07-17

Condition(s): Oncology - Glioblastoma (GBM)
Product: ADI-PEG-20, Troriluzole, AZD1390

Primary endpoint: Overall Survival defined from the time of randomization to death from any cause
Endpoint(s): Progression-Free Survival defined as the time from randomization to clinically determined progression or death from any cause, Tumor Response: complete response, partial response, progressive disease, stable disease, Duration of Response: - Complete Response and Partial Response defined as time from date of response to date of clinically determined disease progression or death from any cause

Source: https://euclinicaltrials.eu/ctis-public/view/2024-511452-40-00